EU clinical trial 2023-508178-27-00: Dose Escalation and Dose Expansion Study of Elironrasib and Daraxonrasib as Monotherapies and Combination Therapy in Patients with Advanced KRAS G12C-mutated Solid Tumors
Protocol code: RMC-6291-101
Sponsor: Revolution Medicines Inc. (Pharmaceutical company). Phase: Phase I and Phase II (Integrated)- Other. Countries: Netherlands (ongoing, recruiting), France (ongoing, recruiting), Germany (ongoing, recruiting), Spain (ongoing, recruiting), Italy (ongoing, recruiting).
Therapeutic area(s): Diseases [C] - Neoplasms [C04]
Gender: Female, Male. Age: 18-64 years, 65+ years. Enrolment: 300.
Status: Ongoing, recruiting. Start date (EU): 2024-07-10. Decision date: 2024-06-10. Results received: No. Last updated: 2026-07-02.
Decision dates by country: NL: 2024-06-12, FR: 2024-06-17, ES: 2024-06-10, DE: 2024-06-13, IT: 2024-06-12

Condition(s): Participants with Advanced KRASG12C-Mutated Solid Tumors

Source: https://euclinicaltrials.eu/ctis-public/view/2023-508178-27-00